EU clinical trial 2023-506014-47-00: A Phase I/randomized Phase II, open-label multicenter trial to evaluate the safety, tolerability, and efficacy of mFOLFIRINOX with or without BNT321 as adjuvant therapy following curative resection in patients with pancreatic adenocarcinoma
Protocol code: BNT321-02
Sponsor: BioNTech SE (Pharmaceutical company). Phase: Phase I and Phase II (Integrated)- Other. Countries: Denmark (not authorised), Spain (not authorised), Germany (not authorised), France (not authorised).
Therapeutic area(s): Diseases [C] - Digestive System Diseases [C06]; Diseases [C] - Neoplasms [C04]
Gender: Female, Male. Age: 18-64 years, 65+ years. Enrolment: 117.
Status: Not authorised. Decision date: 2024-02-12. Results received: No. Last updated: 2024-02-19.
Decision dates by country: DK: 2024-02-12, FR: 2024-02-19, DE: 2024-02-15, ES: 2024-02-13

Condition(s): Resected (R0 or R1) pancreatic ductal adenocarcinoma
Product: Calciumfolinat HEXAL 10 mg/ml Injektionslösung, Irinotecan HCl AqVida 20 mg/ml Konzentrat zur Herstellung einer Infusionslösung, BNT321, FLUOROURACIL, Oxaliplatin AqVida 5 mg/ml Konzentrat zur Herstellung einer Infusionslösung

Primary endpoint: For phase I: The proportion (%) of patients who received at least one dose of investigational medicinal product (IMP) reporting: Incidence and occurrence of treatment-emergent adverse events (TEAEs) including Grade ≥3, serious, fatal TEAE by relationship. Occurrence of DLTs within a cohort during the DLT evaluation period., For phase II: In patients who are randomized into the trial: Disease-free survival (DFS) defined as the time from randomization to occurrence of any of the following: Locoregional recurrence or distant metastasis as determined by an independent central radiology assessment. Occurrence of second primary (same or other) cancer as determined by an independent central radiology assessment. Death from any cause.
Endpoint(s): For Phase I and II. In patients who are enrolled/randomized into the trial: Overall survival (OS) defined as the time from first dose of trial treatment to death from any cause., For Phase I and II. In patients who are enrolled/randomized into the trial: RFS is defined as the time from randomization to occurrence of any of the following events, whichever occurs first: Locoregional recurrence or distant metastasis as determined by the investigator. Death from any cause., For Phase I and II. In patients who are dosed with at least one dose of investigational medicinal product (IMP) and who have evaluable pharmacokinetic (PK) data: PK parameters derived from serum concentration of IMP, including mean AUC, mean Cmax, and median tmax in Cycles 2 and 3 followed by sparse sampling through end of trial (EOT)., For Phase I and II. In patients who are dosed with at least one dose of investigational medicinal product (IMP): Percentage of patients with detectable anti-drug antibodies (ADA) formation in Cycles 1 and 3, followed by sparse sampling through end of trial (EOT)., For Phase I and II: In all patients who are dosed with at least one dose of investigational medicinal product (IMP): Percentage of patients with detectable and durable antibody-dependent cell-mediated cytotoxicity (ADCC) and/or complement-dependent cytotoxicity (CDC) in Cycles 2 and 4, followed by sparse sampling through end of trial (EOT)., For Phase I and II. In all patients who are dosed with at least one dose of IMP: Change from baseline at end of Cycle 12 for patient-reported health-related quality of life (HRQoL) using EORTC QLQ-C30. Change from baseline at end of Cycle 12 for patient-reported HRQoL using EORTC QLQ-Pan26. Change from baseline at end of Cycle 12 in combined item scores from EORTC QLQ-C30 and EORTC QLQ-Pan26., For Phase II: In patients receiving at least one dose of investigational medicinal product (IMP): Occurrence of treatment-emergent adverse events (TEAEs) within a patient including Grade ≥3, serious, fatal TEAE by relationship. Occurrence of dose reduction and discontinuation of IMP within a patient due to TEAE. Occurrence of abnormal laboratory parameters within a patient.

Source: https://euclinicaltrials.eu/ctis-public/view/2023-506014-47-00